EU clinical trial 2024-520324-29-00: PLatelet aggregation and Aspirin low response in Type One Diabetes and the association with vascular damage and diabetic Nephropathy
Sponsor: Steno Diabetes Center Copenhagen (Hospital/Clinic/Other health care facility). Phase: Therapeutic exploratory (Phase II). Countries: Denmark (authorised, recruitment pending).
Therapeutic area(s): Diseases [C] - Hormonal diseases [C19]; Diseases [C] - Cardiovascular Diseases [C14]
Gender: Female, Male. Age: 18-64 years, 65+ years. Enrolment: 332.
Status: Authorised, recruitment pending. Decision date: 2025-01-22. Results received: No. Last updated: 2025-01-22.

Condition(s): Atherosclerotic cardiovascular disease, Type 1 diabete, Diabetic kidney disease
Product: ACETYLSALICYLIC ACID

Primary endpoint: Investigate platelet aggregation in T1D without/off aspirin treatment, stratified according to degree of albuminuria, compared to healthy controls. Platelet aggregation is determined by arachidonic acid expressed as area under the curve.
Endpoint(s): Investigate platelet aggregation after a minimum of seven days aspirin treatment in T1D, stratified according to degree of albuminuria, compared to healthy controls., Determine the prevalence of plaques and plaque volume in the carotid arteries in subjects with T1D., Examine the association between platelet aggregation and the plaque volume in the carotid arteries in subjects with T1D., Examine the association between platelet aggregation and the plaque volume in the carotid arteries in subjects with T1D., Investigate whether platelet aggregation or plaque volume can predict progression in plaque volume after two years, independently of other risk factors., Investigate if platelet aggregation and change in plaque volume can predict CVD outcome in register-based follow up, independently of other risk factors., Investigate endothelial function and inflammation in T1D and examine the association with platelet aggregation and plaque volume in the carotid arteries.

Source: https://euclinicaltrials.eu/ctis-public/view/2024-520324-29-00